EU clinical trial 2024-519602-12-01: Artesunate, sulfasalazine polyunsaturated fatty acids, and iron in patients with solid tumors.
Sponsor: Hospital De Sant Pau I Santa Tecla (Hospital/Clinic/Other health care facility). Phase: Human Pharmacology (Phase I)- Other. Countries: Spain (authorised, recruitment pending).
Therapeutic area(s): Diseases [C] - Neoplasms [C04]
Gender: Female, Male. Age: 18-64 years, 65+ years. Enrolment: 14.
Status: Authorised, recruitment pending. Decision date: 2025-01-30. Results received: No. Last updated: 2025-01-30.

Condition(s): Cancer

Source: https://euclinicaltrials.eu/ctis-public/view/2024-519602-12-01